EU clinical trial 2023-507536-21-00: A Phase 1/2 Open Label, Dose Escalation and Expansion Study of MDNA11, IL-2 Superkine, Administered Alone or in Combination with an Immune Checkpoint Inhibitor in Patients with Advanced Solid Tumors
Protocol code: MDNA11-01
Sponsor: Medicenna Therapeutics Inc. (Pharmaceutical company). Phase: Phase I and Phase II (Integrated)- First administration to humans. Countries: Poland (ended), Spain (ongoing, recruiting), Ireland (ongoing, recruiting), Portugal (ongoing, recruiting).
Therapeutic area(s): Diseases [C] - Immune System Diseases [C20]; Diseases [C] - Respiratory Tract Diseases [C08]; Diseases [C] - Skin and Connective Tissue Diseases [C17]; Diseases [C] - Digestive System Diseases [C06]; Phenomena and Processes [G] - Immune System Phenomena [G13]
Gender: Female, Male. Age: 18-64 years, 65+ years. Enrolment: 111.
Start date (EU): 2024-10-04. Decision date: 2024-06-24. Results received: No. Last updated: 2026-08-07.
Decision dates by country: PL: 2024-06-24, PT: 2024-11-04, IE: 2024-11-08, ES: 2024-09-20

Condition(s): Advanced Solid Tumors
Product: KEYTRUDA 25 mg/mL concentrate for solution for infusion, MDNA11

Primary endpoint: Dose Escalation/Evaluation (Monotherapy and Combination Therapy): Safety and tolerability will be evaluated with respect to incidence and severity of AEs and SAEs, clinically significant abnormal laboratory parameters, vital signs, and ECG parameters per current CTCAE and incidence of dose limiting toxicities (DLTs)., Dose Escalation/Evaluation (Monotherapy and Combination Therapy): RDE will be evaluated using safety, tolerability, immunological response, PK/PD results and preliminary anti-tumor efficacy data (see secondary objectives)., Dose Expansion (Monotherapy and Combination Therapy): Safety will be evaluated based on incidence, nature and severity of AEs and SAEs, abnormal laboratory parameters, vital signs, and ECG results per CTCAE (currently, v5.0) and incidence of DLTs., Dose Expansion (Monotherapy and Combination Therapy): Assessment by iRECIST and RECIST 1.1: o ORR o CBR o DCR o DOR o TTR o PFS o BOR., Dose Expansion (Monotherapy and Combination Therapy): OS.
Endpoint(s): Dose Escalation/Evaluation (Monotherapy and Combination Therapy): Assessment by iRECIST and RECIST 1.1: o Objective Response Rate (ORR) o Clinical Benefit Rate (CBR) o Disease Control Rate (DCR) o Duration of Response (DOR) o Time to Response (TTR) o Progression Free Survival (PFS) o Best Overall Response (BOR)., Dose Escalation/Evaluation (Monotherapy and Combination Therapy): Overall Survival (OS)., Dose Escalation/Evaluation (Monotherapy and Combination Therapy): PK profile may include but are not limited to maximum concentration (Cmax), time to reach Cmax (Tmax), area under the curve (AUC), clearance (CL), half-life (t1/2), etc., Dose Escalation/Evaluation (Monotherapy and Combination Therapy): Incidence and persistence of anti-drug antibodies (ADA) to MDNA11., Dose Escalation/Evaluation (Monotherapy and Combination Therapy): Measurement of translational parameters., Dose Escalation/Evaluation (Monotherapy and Combination Therapy): Measurement of cytokines., Dose Expansion (Monotherapy and Combination Therapy): Measurement of translational parameters., Dose Expansion (Monotherapy and Combination Therapy): Measurement of biomarkers, including but not limited to immune cell lineages and markers of functional status such as determined by quantitative multiparameter immunofluorescence analysis., Dose Expansion (Monotherapy and Combination Therapy): PK profile may include but are not limited to Cmax, Tmax, AUC, CL, t1/2, etc., Dose Expansion (Monotherapy and Combination Therapy): Incidence and persistence of ADA to MDNA11., Exploratory (applicable to all study parts except where indicated): Measurement of translational parameters., Exploratory (applicable to all study parts except where indicated): Effect of baseline prognostic factors [e.g., lymphocyte count, lymphocyte to neutrophil ratio (LNR), C-Reactive Protein (CRP) levels, Lactate Dehydrogenase (LDH), etc.] on efficacy endpoints., Exploratory (applicable to all study parts except where indicated): Exposure-pharmacodynamic relationship based on MDNA11 serum PK parameters and select markers in the peripheral blood and/or tumor biopsy samples.

Source: https://euclinicaltrials.eu/ctis-public/view/2023-507536-21-00